EU clinical trial 2026-526022-41-00: A double-blind, prospective, randomised, placebo-controlled, single-centre, proof-of-principle trial in healthy volunteers to investigate safety, local tolerability, pharmacokinetics, and pharmacodynamics of Asacaine after topical administration on skin exposed to ultraviolet B radiation
Protocol code: AUX001
Sponsor: Auxesis Pharma Holding AB (publ) (Pharmaceutical company). Phase: Human Pharmacology (Phase I)- First administration to humans. Countries: Sweden (authorised, recruitment pending).
Therapeutic area(s): Diseases [C] - Skin and Connective Tissue Diseases [C17]
Gender: Female, Male. Age: 18-64 years. Enrolment: 12.
Status: Authorised, recruitment pending. Decision date: 2026-06-30. Results received: No. Last updated: 2026-06-30.

Condition(s): Topical pain

Source: https://euclinicaltrials.eu/ctis-public/view/2026-526022-41-00